EU clinical trial 2023-503903-27-00: CT7001_002 (SUMIT-BC) - An open-label Interventional, Multicenter, Randomized, Phase 2 Study of Fulvestrant with or without Samuraciclib in Participants with Metastatic or Locally Advanced Hormone Receptor Positive and Human Epidermal Growth Factor Receptor 2 Negative Breast Cancer
Sponsor: Carrick Therapeutics Limited (Pharmaceutical company). Phase: Therapeutic exploratory (Phase II). Countries: Spain (ended), Hungary (ended).
Therapeutic area(s): Diseases [C] - Neoplasms [C04]
Gender: Female, Male. Age: 18-64 years. Enrolment: 24.
Status: Ended. Start date (EU): 2023-10-11. End date (EU): 2025-09-02. End date: 2025-09-03. Decision date: 2023-09-25. Results received: No. Last updated: 2025-07-17.
Decision dates by country: HU: 2023-12-11, ES: 2023-09-25

Condition(s): metastatic or locally advanced Hormone Receptor positive and Human Epidermal Growth Factor Receptor 2 negative breast cancer
Product: Faslodex 250 mg solution for injection., CT7001 Tablet

Primary endpoint: Clinical benefit response (CBR) (complete response [CR], partial response [PR], or stable disease [SD] (≥ 24 weeks after randomization)).
Endpoint(s): Adverse events (AEs) and laboratory abnormalities as graded by National Cancer Institute (NCI) Common Terminology Criteria for Adverse Events (CTCAE) v5.0, Progression free survival (PFS); Objective response rate (ORR); Duration of response (DOR)., Samuraciclib: Cmax and Ctrough; Fulvestrant: Ctrough.

Source: https://euclinicaltrials.eu/ctis-public/view/2023-503903-27-00